EU clinical trial 2024-514190-21-00: Long-term Follow-up (LTFU) Study of Participants in any iECURE Protocol Using an Investigational Product
Protocol code: ECUR-LTFU
Sponsor: Iecure Inc. (Pharmaceutical company). Phase: Phase I and Phase II (Integrated)- First administration to humans. Countries: Spain (authorised, recruitment pending), France (ongoing, recruiting).
Therapeutic area(s): Diseases [C] - Congenital, Hereditary, and Neonatal Diseases and Abnormalities [C16]
Gender: Male. Age: 0-17 years. Enrolment: 3.
Start date (EU): 2026-06-29. Decision date: 2026-06-18. Results received: No. Last updated: 2026-06-23.
Decision dates by country: FR: 2026-06-18, ES: 2026-06-23

Condition(s): Ornithine Transcarbamylase Deficiency (OTC)
Product: ECUR-506D, ECUR-506A

Primary endpoint: • AE and SAE (incidence, severity, seriousness, and relatedness) • Physical exam (including length/height and weight) • Vital signs • Neurologic exam • Blood safety tests including hematology, serum chemistry, liver function tests, coagulation tests, serum PCSK9 • Urinalysis • 12 lead ECG
Endpoint(s): 1. Vector PK in blood and shedding in plasma, saliva, urine and feces for dosed participants, 2. Percent liver transduction, 3. Number of hyperammonemic crises (HAC), 4. Among participants who experience HAC with associated neurological status change and are hospitalized: a. Daily ammonia levels for duration of hospitalization for each event b. Duration of hospitalization for each event c. Requirement for Intensive Care Unit (ICU) care during hospitalization for each event and total time in ICU for each event, 5. Number of HAC with the following severities: a. Mild: adjustment of dietary protein intake and oral scavenger medication b. Moderate: cessation of dietary protein intake and initiation of IV scavenger therapy c. Severe: requirement for hemodialysis, 6. Scavenger drug dose per body surface area (BSA), 7. Protein allowance g/kg, 8. Blood urea nitrogen measurements, 9. Time to liver transplant from Day 1 (Parent Protocol) for participants who are dosed and Day -1 (Parent Protocol) for participants who are not dosed to end of study EOS (LTFU Protocol), 10. Transplant free survival a. Time to liver transplant or any-cause death from dosing to EOS, 11. Overall survival a. Time to any-cause death from dosing to EOS. Survival measured from Day 1 (Parent Protocol) for participants who are dosed and Day -1 (Parent Protocol) for participants who are not dosed to end of study EOS (LTFU Protocol)., • Antibody response to AAV capsid, and to nuclease and therapeutic transgenes • Plasma ammonia, citrulline and glutamine • Urinary nitrogen to urinary creatinine ratio • Future DNA analysis of WBCs collected in a parent trial may be performed only in the event of an observed genomic safety signal • Developmental assessments as measured by age-appropriate Bayley Scale of Infant Development IV (BSID-IV) and Kaufman Assessment Battery for Children – Second Edition Normative Update (KABC-II NU)

Source: https://euclinicaltrials.eu/ctis-public/view/2024-514190-21-00